EU clinical trial 2022-502660-20-00: A PHASE 3, OPEN-LABEL, RANDOMIZED STUDY TO COMPARE THE EFFICACY AND SAFETY OF ODRONEXTAMAB (REGN1979), AN ANTI-CD20 X ANTI-CD3 BISPECIFIC ANTIBODY, VERSUS INVESTIGATOR’S CHOICE IN PREVIOUSLY UNTREATED PARTICIPANTS WITH FOLLICULAR LYMPHOMA (OLYMPIA-1)
Protocol code: R1979-HM-2298
Sponsor: Regeneron Pharmaceuticals Inc. (Pharmaceutical company). Phase: Therapeutic confirmatory (Phase III). Countries: Czechia (ongoing, recruitment ended), Germany (ongoing, recruitment ended), Spain (ongoing, recruitment ended), Italy (ongoing, recruitment ended), Poland (ongoing, recruitment ended), Belgium (ended), Austria (ongoing, recruitment ended), France (ongoing, recruitment ended).
Therapeutic area(s): Diseases [C] - Hemic and Lymphatic Diseases [C15]
Gender: Female, Male. Age: 18-64 years, 65+ years. Enrolment: 322.
Start date (EU): 2024-01-23. Decision date: 2023-10-05. Results received: No. Last updated: 2026-08-08.
Decision dates by country: BE: 2023-10-10, PL: 2023-10-10, CZ: 2023-10-05, ES: 2023-10-09, AT: 2023-10-10, FR: 2024-03-27, DE: 2023-10-10, IT: 2023-10-10

Condition(s): Follicular lymphoma
Product: PREDNISONE, PREDNISOLONE, VINCRISTINE SULFATE, DOXORUBICIN HYDROCHLORIDE, BENDAMUSTINE HYDROCHLORIDE, Odronextamab, Truxima 500 mg concentrate for solution for infusion, Odronextamab, Truxima 100 mg concentrate for solution for infusion, CYCLOPHOSPHAMIDE

Primary endpoint: Part 1: Incidence of dose-limiting toxicities (DLTs) for odronextamab, Part 1: Incidence of treatment-emergent adverse events (TEAEs) of odronextamab, Part 1: Severity of TEAEs of odronextamab, Part 2: CR30 as assessed by independent central review
Endpoint(s): Part 1: Concentrations of odronextamab in serum, Part 1: Occurrence of anti-drug antibodies (ADAs) to odronextamab, Part 1: Magnitude of ADAs to odronextamab, Part 1: Objective response as assessed by the investigator, Part 2: Progression-free survival (PFS) as assessed by independent central review, Part 2: Event-free survival (EFS) as assessed by independent central review, Part 2: OS, Part 2: Overall mean change in physical function [European Organization for Research and Treatment of Cancer Quality of Life Core Questionnaire 30 (EORTC-QLQ-C30)], Part 2: CR30 as assessed by local investigator, Part 2: PFS as assessed by local investigator, Part 2: EFS as assessed by local investigator, Part 2: Objective response assessed by local investigator, Part 2: Objective response assessed by independent central review, Part 2: Duration of response (DOR) assessed by independent central review, Part 2: DOR assessed by local investigator, Part 2: Time to next anti-lymphoma treatment (TTNT), Part 2: Incidence of TEAEs, Part 2: Severity of TEAEs, Part 2: Odronextamab concentrations in serum during the induction period, Part 2: Odronextamab concentrations in serum during the maintenance period, Part 2: Occurrence of ADAs to odronextamab, Part 2: Magnitude of ADAs to odronextamab, Part 2: Overall mean changes in scores of patient reported outcomes (PROs), as measured by the validated instruments EORTCQLQ- C30, Part 2: Overall mean changes in scores of PROs, as measured by the validated instruments Functional Assessment of Cancer Therapy–Lymphoma (FACT-LymS), Part 2: Overall mean changes in scores of PROs, as measured by the validated instruments EuroQol-5 Dimension-5 Level Scale (EQ-5D- 5L), Part 2: Change in PGIS and PGIC, Part 2: Change in score of GP5 item in the participant population

Source: https://euclinicaltrials.eu/ctis-public/view/2022-502660-20-00